EU clinical trial 2023-507988-19-00: First-in-human safety study of pancreatic islet transplantation without immune suppression in adult subjects with type 1 diabetes
Protocol code: UP421-ET1D
Sponsor: Uppsala University Hospital (Hospital/Clinic/Other health care facility). Phase: Human Pharmacology (Phase I)- First administration to humans. Countries: Sweden (ongoing, recruitment ended).
Therapeutic area(s): Diseases [C] - Nutritional and Metabolic Diseases [C18]
Gender: Female, Male. Age: 18-64 years. Enrolment: 2.
Status: Ongoing, recruitment ended. Start date (EU): 2024-03-08. Decision date: 2023-11-16. Results received: No. Last updated: 2026-01-30.

Condition(s): Diabetes type I

Source: https://euclinicaltrials.eu/ctis-public/view/2023-507988-19-00